EU clinical trial 2024-511126-31-00: A multi-center, randomized, double-blind, placebo controlled, parallel-group Phase IIIb study evaluating the effect of inclisiran on atherosclerotic plaque progression assessed by coronary computed tomography angiography (CCTA) in participants with a diagnosis of non-obstructive coronary artery disease without previous cardiovascular events (VICTORION-PLAQUE)
Protocol code: CKJX839D12303
Sponsor: Novartis Pharma AG (Pharmaceutical company). Phase: Therapeutic confirmatory (Phase III). Countries: Hungary (ended), Ireland (ongoing, recruitment ended), Italy (ongoing, recruitment ended), Belgium (ended), France (ongoing, recruitment ended), Spain (ongoing, recruitment ended).
Therapeutic area(s): Diseases [C] - Cardiovascular Diseases [C14]
Gender: Female, Male. Age: 18-64 years, 65+ years. Enrolment: 173.
Start date (EU): 2022-08-16. Decision date: 2024-07-11. Results received: No. Last updated: 2026-05-20.
Decision dates by country: IT: 2024-07-22, BE: 2024-07-18, IE: 2024-07-12, FR: 2024-08-06, HU: 2024-07-17, ES: 2024-07-11

Condition(s): Non-obstructive Coronary Artery Disease
Product: ROSUVASTATIN, ROSUVASTATIN, INCLISIRAN, Placebo to KJX839 (Inclisiran sodium) 0 mg/1.5 mL solution for injection in pre-filled syringe, ROSUVASTATIN, ATORVASTATIN, ATORVASTATIN, ROSUVASTATIN, ATORVASTATIN, ATORVASTATIN

Primary endpoint: Percentage change from baseline to Month 24 in total coronary atheroma volume
Endpoint(s): Percentage change in LDL-C from baseline to Month 24, Percentage change in low attenuation plaque volume evaluated by CCTA, Percentage of participants with progression, regression, or no change of total plaque atheroma, incidence, severity, and relationship to study drug of TEAEs and Serious Adverse Events (SAEs)

Source: https://euclinicaltrials.eu/ctis-public/view/2024-511126-31-00